EU clinical trial 2024-518878-14-01: Evaluating the safety of shortened infusion tiMes for dIfferent oNcological immUnoThErapies; An observational prospective study (MINUTE)
Sponsor: Isala Klinieken Stichting (Hospital/Clinic/Other health care facility). Phase: Therapeutic use (Phase IV). Countries: Netherlands (ongoing, recruiting).
Therapeutic area(s): Not possible to specify
Gender: Female, Male. Age: 18-64 years, 65+ years. Enrolment: 1261.
Status: Ongoing, recruiting. Start date (EU): 2024-11-25. Decision date: 2024-11-25. Results received: No. Last updated: 2025-12-18.

Condition(s): Inflammatory bowel disease, Rheumatic disease, Oncology
Product: OPDIVO 10 mg/mL concentrate for solution for infusion., Remicade 100 mg powder for concentrate for solution for infusion., Herceptin 150 mg powder for concentrate for solution for infusion, KEYTRUDA 25 mg/mL concentrate for solution for infusion, IMFINZI 50 mg/mL concentrate for solution for infusion., Vectibix 20 mg/ml concentrate for solution for infusion, Entyvio 300 mg powder for concentrate for solution for infusion, Truxima 500 mg concentrate for solution for infusion, Tecentriq 1 875 mg solution for injection, YERVOY 5 mg/ml concentrate for solution for infusion, RoActemra 20 mg/mL concentrate for solution for infusion, Perjeta 420 mg concentrate for solution for infusion, Avastin 25 mg/ml concentrate for solution for infusion.

Primary endpoint: Numer of infusion related reactions, Grade of IRR
Endpoint(s): Efficacy treatment parameters (progression, remission), plasma levels of the administered drug, Patient reported expierence measurements, number of treatments needed, death, switchting of treatmet

Source: https://euclinicaltrials.eu/ctis-public/view/2024-518878-14-01